EU clinical trial 2024-516050-22-00: A DOUBLE BLIND, RANDOMIZED, PLACEBO-CONTROLLED, ADD-ON TRIAL EVALUATING EFFICACY AND SAFETY OF HYDROXYCHLOROQUINE IN EARLY SYSTEMIC SCLEROSIS (SSc)- HYDROXYSSc
Protocol code: HYDROXYSSc
Sponsor: Azienda Ospedaliero-Universitaria Policlinico Umberto I (Hospital/Clinic/Other health care facility). Phase: Therapeutic confirmatory (Phase III). Countries: Italy (ended).
Therapeutic area(s): Diseases [C] - Immune System Diseases [C20]
Gender: Female, Male. Age: 18-64 years, 65+ years. Enrolment: 151.
Status: Ended. Start date (EU): 2023-07-13. End date (EU): 2026-01-08. Decision date: 2024-08-12. Results received: No. Last updated: 2025-01-20.

Condition(s): Systemic Sclerosis (SSc) is a rare and orphan disease (DPCM 12 gennaio 2017-GU SG n°65-S.O. n°15 - 18/03/2017), characterized by immunological, vascular and fibrotic abnormalities. The estimated incidence is 18 to 20 cases per million population year and a prevalence of 100 to 300 cases per million population. In Europe the prevalence rate is estimated around 200 per million while in the Italian population around 20000 persons suffer from this form of autoimmune disease.
Product: Placebo tablets LFM, PLAQUENIL 200 mg compresse rivestite

Primary endpoint: To evaluate efficacy of HCQ add-on compared to placebo by assessing changes from baseline of American College of Rheumatology Combined Response Index for Systemic Sclerosis (CRISS)(Khanna D 2009) at week 52.
Endpoint(s): econdary efficacy endpoints: To evaluate efficacy of HCQ add-on by assessing change from baseline of: 1. European Systemic Sclerosis Global Disease Activity Index (ESScGDAI) at week 52, Secondary efficacy endpoints: To evaluate efficacy of HCQ add-on by assessing change from baseline of: Visual Analogue Scale (VAS) for pain at weeks 26 and 52, Secondary efficacy endpoints: To evaluate efficacy of HCQ add-on by assessing change from baseline of:Morning stiffness (MS) duration (in minutes) at weeks 26 and 52, Secondary efficacy endpoints: To evaluate efficacy of HCQ add-on by assessing change from baseline of:The FACIT fatigue Index at week 26 and 52, Secondary efficacy endpoints: To evaluate efficacy of HCQ add-on by assessing change from baseline of:Raynaud Condition Score (RCS) scale at week 26 and 52, Secondary efficacy endpoints: To evaluate efficacy of HCQ add-on by assessing change from baseline of:Naifold Capillaroscopy (NC) main parameters and CSURI (Capillaroscopic Skin Ulcer Risk Index) at week 52

Source: https://euclinicaltrials.eu/ctis-public/view/2024-516050-22-00